EU clinical trial 2024-516865-35-01: Head-to-Head Comparison of the Efficacy and Safety of All Commercially Available Botulinum Neurotoxin Type A Products for the Treatment of Glabellar Rhytides: A Multicenter, Triple-Blind, Randomized Controlled Trial
Sponsor: Stichting Amsterdam UMC (Hospital/Clinic/Other health care facility). Phase: Therapeutic use (Phase IV). Countries: Netherlands (authorised, recruitment pending).
Therapeutic area(s): Diseases [C] - Skin and Connective Tissue Diseases [C17]
Gender: Female. Age: 18-64 years, 65+ years. Enrolment: 390.
Status: Authorised, recruitment pending. Decision date: 2025-03-18. Results received: No. Last updated: 2025-09-30.

Condition(s): Glabellar frown rhytides (wrinkles).
Product: BOCOUTURE 50 units powder for solution for injection, NUCEIVA 50 Units powder for solution for injection, Azzalure, 125 Speywood units, powder for solution for injection, Relfydess, 100 eenheden/ml, oplossing voor injectie, VISTABEL, 4 Allergan Units/0.1 ml, Powder for solution for injection

Primary endpoint: The primary outcome measure will be the time until loss of treatment effect. This is specifically quantified as the period until a loss of effect is observed and measured as the percentage of participants who maintain at least a 1-point improvement in glabellar line severity at maximum frown from baseline to week 16, assessed using the "four-point clinical severity score for glabellar frown lines" developed by Honeck.
Endpoint(s): Secondary Outcome Related to Clinical Efficacy: (Duration) a. Duration of Treatment Effect (Detailed Analysis): While the primary outcome captures the time until loss of effect at week 16, as secondary outcomes we will employ Kaplan-Meier survival curves and Cox proportional hazards models to analyze the time to complete loss of effect across the entire study duration. This analysis will provide additional insights into the robustness of the treatment's effects, allowing us to identify the media, Secondary Outcome Related to Safety: a. Incidence of Adverse Events (AEs): Monitors occurrences of adverse events such as ptosis, strabismus, and eyelid sensory disorders throughout the study period., Patient-Reported Outcomes (assessed from baseline to week 16): a. Quality of Life (FACE-Q Psychological Wellbeing): Evaluates the impact of treatment on psychological wellbeing. b. Social Functioning (FACE-Q Social):44 Assesses the effect of treatment on social interaction capabilities. c. Participant Self-Assessment of Satisfaction (FACE-Q Satisfaction): Measures patient satisfaction with treatment outcomes., Psychological Assessments: a. Hospital Anxiety and Depression Scale (HADS): Assessed from baseline to week 4 to monitor changes in anxiety and depression levels. b. Migraine Disability Assessment (MIDAS) / Headache Impact Test (HIT-6): Assessed from baseline to week 4 to evaluate the impact on headache and migraine symptoms., Side Effects (assessed within the first two weeks): a. FACE-Q Early Life Impact: Evaluates immediate post-treatment effects on patients’ daily life.

Source: https://euclinicaltrials.eu/ctis-public/view/2024-516865-35-01